EU clinical trial 2025-523828-51-00: IB1001-304: Effects of N-Acetyl-L-Leucine on CACNA1A Disorders: A Phase III, randomized, placebo-controlled, double-blind, crossover study
Sponsor: Intrabio Limited, IntraBio Inc (Pharmaceutical company, Industry). Phase: Therapeutic confirmatory (Phase III). Countries: Italy (authorised, recruitment pending), Germany (authorised, recruitment pending), Austria (authorised, recruitment pending), Greece (authorised, recruitment pending).
Therapeutic area(s): Diseases [C] - Nervous System Diseases [C10]
Gender: Female, Male. Age: 0-17 years, 18-64 years, 65+ years. Enrolment: 25.
Status: Authorised, recruitment pending. Decision date: 2026-03-25. Results received: No. Last updated: 2026-06-17.
Decision dates by country: AT: 2026-04-12, DE: 2026-03-25, IT: 2026-06-08, GR: 2026-06-17

Condition(s): CACNA1A Disorders
Product: N-Acetyl-L-Leucine, granules for suspension

Primary endpoint: The primary endpoint measure is the Scale for the Assessment and Rating of Ataxia (SARA). SARA is an eight-item clinical rating scale (range 0–40, where 0 is the best neurological status and 40 the worst). It is a reliable and valid clinical scale with a high internal consistency that measures the severity of ataxia and increases with ataxia disease stage.
Endpoint(s): • Spinocerebellar Ataxia Functional Index (SCAFI) • Functional Scale for the Assessment and Rating of Ataxia (f-SARA) [US only - key secondary endpoint in the US] • Quality of Life EQ-5D-5L for patients aged ≥18; EQ-5D-Y for children aged <18 years • Neuro Quality of Life – Upper Extremity Function (NeuroQOL-UEF) assessed by the Patient or the Caregiver (if patient unable to complete)

Source: https://euclinicaltrials.eu/ctis-public/view/2025-523828-51-00